EU clinical trial 2022-501389-23-02: A 3-month, phase 2, single-blind, randomised, no-treatment controlled study assessing efficacy and safety of Renaparin® for improvement of kidney graft function in deceased-donor transplant recipients, with an additional 9-month follow-up.
Protocol code: RENAPAIR 02
Sponsor: Corline Biomedical AB (Pharmaceutical company). Phase: Therapeutic exploratory (Phase II). Countries: Austria (authorised, recruitment pending), Germany (authorised, recruitment pending).
Therapeutic area(s): Diseases [C] - Male Urogenital Diseases [C12]; Diseases [C] - Female Urogenital Diseases and Pregnancy Complications [C13]
Gender: Female, Male. Age: 18-64 years, 65+ years. Enrolment: 52.
Status: Authorised, recruitment pending. Decision date: 2023-08-24. Results received: No. Last updated: 2025-08-31.
Decision dates by country: DE: 2023-08-24, AT: 2023-08-28

Condition(s): end-stage renal disease or otherwise an insufficient kidney function
Product: Renaparin

Primary endpoint: The primary endpoint is the estimated glomerular filtration rate (eGFR) at Month 3, calculated using the MDRD 4 equation.
Endpoint(s): Incidence of DGF (need for dialysis during first 7 days post-transplantation)., Serum creatinine on Days 1-7, Day 30, and Months 3, 6, and 12., eGFR on Days 1-7, Day 30, Month 6 and Month 12., Severity of DGF, i.e., total number of dialysis sessions received by a patient through Day 30 in patients requiring dialysis within first 7 days post-transplantation., Incidence of functional DGF (fDGF), i.e., failure of serum creatinine to decrease by at least 10% daily on 3 consecutive days during the first 7 days post-transplantation, irrespective of dialysis requirements, but discounting creatinine decrements because of dialysis itself., DGF duration (days); calculated from the date of kidney transplantation until the date of last dialysis session in patients who required at least one dialysis session within the first 7 days post-transplantation., The proportion of patients with immediate graft function (IGF), i.e., patients with creatinine reduction ratio (CRR) ≥30% between Day 1 and Day 2 post-transplant, irrespective of whether or not they had a single dialysis session within the first 7 days post-transplant., Proportion of patients with primary non-function (PNF), i.e., those who receive an allograft that never functions., The time to first dialysis (days) excluding patients with PNF., Urine output on Days 1-3.

Source: https://euclinicaltrials.eu/ctis-public/view/2022-501389-23-02